EU clinical trial 2024-516816-72-00: A prospective interventional randomized controlled trial to assess the effect of low dose acetylsalicylic acid as a preventive treatment of preeclampsia in pregnant women who underwent frozen embryo transfer
Sponsor: Centre Hospitalier Universitaire De Liege (Hospital/Clinic/Other health care facility). Phase: Therapeutic confirmatory (Phase III). Countries: Belgium (ended).
Therapeutic area(s): Diseases [C] - Female Urogenital Diseases and Pregnancy Complications [C13]
Gender: Female. Age: 18-64 years. Enrolment: 276.
Status: Ended. Start date (EU): 2022-04-27. End date (EU): 2026-02-05. Decision date: 2024-09-12. Results received: No. Last updated: 2024-09-12.

Condition(s): preeclampsia
Product: Asaflow 80 mg, maagsapresistente tabletten

Primary endpoint: Mean number of women suffering from preeclampsia in the treated and not treated groups.

Source: https://euclinicaltrials.eu/ctis-public/view/2024-516816-72-00